EU clinical trial 2024-518793-14-00: Antimicrobial treatment of laryngeal leukoplakia
Sponsor: HUS-Yhtymae (Hospital/Clinic/Other health care facility). Phase: Therapeutic use (Phase IV). Countries: Finland (authorised, recruitment pending).
Therapeutic area(s): Diseases [C] - Otorhinolaryngologic Diseases [C09]
Gender: Female, Male. Age: 18-64 years, 65+ years. Enrolment: 90.
Status: Authorised, recruitment pending. Decision date: 2024-10-30. Results received: No. Last updated: 2024-10-30.

Condition(s): laryngeal leukoplakia
Product: Diflucan 100 mg kovat kapselit, Kefexin 500 mg tabletti, kalvopäällysteinen

Primary endpoint: disappearance of leukoplakia

Source: https://euclinicaltrials.eu/ctis-public/view/2024-518793-14-00